EU clinical trial 2025-520850-13-00: StroKE34 Study Protocol: a randomized Controlled Phase IIa trial of intra-arterial Cd34+ Cells in acute ischemic Stroke
Protocol code: 2017-002456-88
Sponsor: Unidade Local De Saude De Coimbra E.P.E. (Hospital/Clinic/Other health care facility). Phase: Therapeutic exploratory (Phase II). Countries: Portugal (authorised, recruitment pending).
Therapeutic area(s): Diseases [C] - Nervous System Diseases [C10]
Gender: Female, Male. Age: 18-64 years, 65+ years. Enrolment: 30.
Status: Authorised, recruitment pending. Decision date: 2025-01-30. Results received: No. Last updated: 2025-01-30.

Condition(s): Ischemic Stroke
Product: Strimvelis 1-10 x 106 cells/mL dispersion for infusion

Primary endpoint: Infarct volume at three months after ischemic stroke, Volume de enfarte aos três meses após AVC isquémico
Endpoint(s): Functional outcome: modified Rankin Scale (mRS), Stroke Impact Scale (SIS), Cognitive performance: Montreal Cognitive Assessment scale (MoCA), Functional Independence and performance : Barthel Scale; Upper limb Capacity - Stroke Upper Limb Capacity Scale – SULCS; Evaluation of gait speed (TEST 10 METERS); Evaluation of temporospacial gait (GAIT RIte speed), Depression - Hospital Anxiety and Depression Scale- (HADS Scale), Qualitiy of life assessment - EuroQol Scale( EQ-5D), Deglutition: Teste Rápido de Identificação da Disfagia (TRIDIS); Functional Oral Intake de Identificação da Disfagia (FOIS), Aphasia: Bateria de Avaliação de Afasia de Lisboa - BAAL; The Aphasia Rapid Test (ART)

Source: https://euclinicaltrials.eu/ctis-public/view/2025-520850-13-00